EU clinical trial 2025-523860-19-00: A Multicenter, Open-Label, Dose Escalation Study of the Safety, Tolerability, and Efficacy of Budiodarone for the Treatment of Subjects with Non-permanent Atrial Fibrillation
Protocol code: CLN-209
Sponsor: Xyra LLC (Pharmaceutical company). Phase: Phase II and Phase III (Integrated). Countries: Poland (ongoing, recruiting).
Therapeutic area(s): Diseases [C] - Cardiovascular Diseases [C14]
Gender: Female, Male. Age: 18-64 years, 65+ years. Enrolment: 100.
Status: Ongoing, recruiting. Start date (EU): 2026-07-09. Decision date: 2026-04-20. Results received: No. Last updated: 2026-05-15.
Decision dates by country: PL: 2026-04-22

Condition(s): Non-permanent Atrial Fibrillation
Product: BUDIODARONE

Primary endpoint: Safety: • Incidence of TEAE and treatment-emergent serious adverse events (TESAE). • Incidence of AESI • Mortality and Clinical Morbidity Events: o Death o Resuscitated sudden cardiac death (SCD) including appropriate implanted cardiac defibrillator (ICD) discharge o Cardiovascular hospitalization o Stroke or another thromboembolic event • Physical Exam assessments and abnormalities. • Vital sign assessments and abnormalities. • Clinical laboratory assessment and abnormalities. o Thyroid functio, Primary Efficacy: • Proportion of participants that have no LEAF (uninterrupted episode of AF that is 5 hours or longer in duration or cumulative duration of AF in any rolling 24-hour period that is greater than 5 hours) in the final month of treatment., Exploratory Endpoint: • The proportion of participants with no LEAF episodes lasting one hour or longer in the final month of budiodarone treatment
Endpoint(s): Secondary Efficacy: • Change in percent AFSS during final month of treatment compared to baseline for multiple doses of budiodarone. • PGI-C during the final month of treatment. • Percent change in AFB during final month of treatment compared to baseline.

Source: https://euclinicaltrials.eu/ctis-public/view/2025-523860-19-00